EU clinical trial 2022-501618-70-00: A Phase 1/2 Open-Label Multicenter Trial to Characterize the Safety, Tolerability, and Preliminary Efficacy of CFT1946 as Monotherapy and Combination Therapy in Subjects with BRAF-V600 Mutant Solid Tumors.
Protocol code: CFT1946-1101
Sponsor: C4 Therapeutics Inc. (Pharmaceutical company). Phase: Phase I and Phase II (Integrated)- First administration to humans. Countries: France (ended), Spain (ended), Italy (ended), Germany (ended).
Therapeutic area(s): Diseases [C] - Neoplasms [C04]
Gender: Female, Male. Age: 18-64 years, 65+ years. Enrolment: 59.
Status: Ended. Start date (EU): 2023-06-27. End date (EU): 2025-10-08. End date: 2025-11-05. Decision date: 2023-05-16. Results received: No. Last updated: 2025-08-28.
Decision dates by country: IT: 2024-10-17, FR: 2023-05-24, DE: 2024-09-30, ES: 2023-05-24

Condition(s): BRAF-V600 Mutant Solid Tumors including Melanoma, Non-small cell lung cancer, Colorectal cancer and Anaplastic thyroid carcinoma.
Product: CFT1946, CFT1946, CETUXIMAB, CFT1946, Trametinib, CETUXIMAB, Trametinib

Primary endpoint: 1. Incidence of dose limiting toxicities., 2. Frequency and severity of Adverse Events and Serious Adverse Events., 3. Changes between baseline and post baseline safety assessments., 4. Frequency of dose interruptions and dose reductions., 5. Frequency of Adverse Events leading to discontinuation of study treatment(s)., 6. Overall response rate measured by RECIST v1.1 criteria per Independent Review Committee.
Endpoint(s): 1. All primary endpoints except incidence of dose limiting toxicities., 2. Single dose and multiple dose pharmacokinetics of CFT1946 (monotherapy and combination) and trametinib., 3. Pharmacokinetics-QT interval corrected for heart rate using Fridericia’s formula relationship., 4. Overall response rate measured by RECIST v1.1 per Investigator assessment., 5. Disease control rate at 3, 6, and 12 months., 6. Progression-free survival., 7. Duration of response., 8. Tumor BRAF degradation PD marker(s)., 9. MAPK pathway inhibition in BRAF tumor., 10. Dose/pharmacokinetic correlation to pharmacodynamic endpoints.

Source: https://euclinicaltrials.eu/ctis-public/view/2022-501618-70-00